EU clinical trial 2022-502867-39-00: Phase 1 First-In-Human Study to Explore the Safety, Tolerability, and Pharmacokinetics of AMG 305 in Subjects With Advanced Solid Tumors
Protocol code: 20220073
Sponsor: Amgen Inc. (Pharmaceutical company). Phase: Human Pharmacology (Phase I)- First administration to humans. Countries: France (ended), Germany (ended), Spain (ended).
Therapeutic area(s): Diseases [C] - Neoplasms [C04]
Gender: Female, Male. Age: 18-64 years, 65+ years. Enrolment: 58.
Status: Ended. Start date (EU): 2023-09-29. End date (EU): 2025-12-12. End date: 2026-01-22. Decision date: 2023-08-23. Results received: No. Last updated: 2025-06-30.
Decision dates by country: ES: 2023-09-13, DE: 2023-08-24, FR: 2023-08-23

Condition(s): Advanced solid tumors including non-small cell lung cancer (NSCLC), mesothelioma, pancreatic adenocarcinoma, head and neck carcinoma, ovarian cancer, cervical carcinoma, uterine carcinoma and breast cancer.

Source: https://euclinicaltrials.eu/ctis-public/view/2022-502867-39-00